EU clinical trial 2024-511743-26-00: Does Increasing Oxygen Nurture Your Symptomatic Ischemic Ulcer Sufficiently?
Sponsor: Amsterdam UMC Stichting (Hospital/Clinic/Other health care facility). Phase: Therapeutic use (Phase IV). Countries: Netherlands (ended), Spain (ended).
Therapeutic area(s): Diseases [C] - Cardiovascular Diseases [C14]
Gender: Female, Male. Age: 18-64 years, 65+ years. Enrolment: 194.
Status: Ended. End date (EU): 2025-06-10. Decision date: 2024-11-18. Results received: No. Last updated: 2024-11-25.
Decision dates by country: ES: 2024-11-25, NL: 2024-11-18

Condition(s): Symptomatic Ischemic Ulcer related to Diabetes
Product: OXYGEN, OXYGEN

Primary endpoint: Major amputation rate after 12-months of follow-up

Source: https://euclinicaltrials.eu/ctis-public/view/2024-511743-26-00